EU clinical trial 2024-520101-39-00: A Phase III, Randomised, Open-Label, Multicentre Study of Datopotamab Deruxtecan or Docetaxel in Previously Treated TROP2-positive Advanced or Metastatic Non-squamous Non-Small Cell Lung Cancer Without Actionable Genomic Alterations (TROPION-Lung17)
Protocol code: D763QC00001
Sponsor: AstraZeneca AB (Pharmaceutical company). Phase: Therapeutic confirmatory (Phase III). Countries: Spain (authorised, recruiting), Poland (ongoing, recruiting), Hungary (ongoing, recruiting), Italy (authorised, recruitment pending), Germany (ongoing, recruiting), France (ongoing, recruiting), Belgium (ongoing, recruiting), Austria (ongoing, recruiting).
Therapeutic area(s): Diseases [C] - Neoplasms [C04]
Gender: Female, Male. Age: 18-64 years, 65+ years. Enrolment: 103.
Start date (EU): 2026-04-01. Decision date: 2026-02-26. Results received: No. Last updated: 2026-07-03.
Decision dates by country: AT: 2026-03-09, BE: 2026-03-02, IT: 2026-03-03, ES: 2026-03-02, PL: 2026-03-07, FR: 2026-03-03, DE: 2026-03-03, HU: 2026-02-26

Condition(s): TROP2 NMR-positive advanced or metastatic non-squamous non-small cell lung cancer without actionable genomic alterations.
Product: Datopotamab deruxtecan, DOCETAXEL

Primary endpoint: To assess the superiority of Dato-DXd vs docetaxel by assessment of PFS by BICR according to RECIST v1.1 in participants with TROP2 QCS-NMR positive non-squamous NSCLC without AGA., To assess the superiority of Dato-DXd vs docetaxel by assessment of OS in participants with TROP2 QCS-NMR positive non-squamous NSCLC without AGA.
Endpoint(s): Objective response rate (ORR), Duration of response (DoR), Time to second progression or death (PFS2), Characterise population PK and its relationship with efficacy and safety endpoints, and evaluate the effects of covariates on PK, efficacy, and safety, Presence of antidrug antibody (ADAs) for Dato-DXd, Time to deterioration (TTD) in pulmonary symptoms, physical functioning, and in GHS/QoL, To assess TROP2 diagnostic test performance and relationship with other tumour-derived biomarkers or diagnostics tests, and support test development, To assess the safety and tolerability of Dato-DXd vs docetaxel in participants with TROP2 QCS-NMR positive non-squamous NSCLC without AGA

Source: https://euclinicaltrials.eu/ctis-public/view/2024-520101-39-00